EU clinical trial 2024-512059-19-00: Multicenter validation trial of [18F]AlF-FAPI-74 for PET imaging of cancer-associated fibroblasts through fibroblast activation protein inhibitors (FAPI) in different tumor types.
Protocol code: S67792
Sponsor: UZ Leuven (Hospital/Clinic/Other health care facility). Phase: Phase II and Phase III (Integrated). Countries: Belgium (ongoing, recruiting).
Therapeutic area(s): Diseases [C] - Neoplasms [C04]
Gender: Female, Male. Age: 18-64 years, 65+ years. Enrolment: 109.
Status: Ongoing, recruiting. Start date (EU): 2025-02-14. Decision date: 2024-12-18. Results received: No. Last updated: 2025-02-20.

Condition(s): Diverse oncological patients with a clinically challenging situation., Oesophagogastric adenocarcinoma (OGA), Pancreatic ductal adenocarcinoma (PDAC)
Product: Telebrix Gastro, 300 mg I/ml, oplossing voor orale of rectale toediening

Primary endpoint: OGA: detection ratio for lymph node and distant metastases (combined)., PDAC: detection ratio for lymph node and distant metastases (combined)., Clinically Challenging Situation: fraction of patients were scan was deemed contributory. This means: 1. [18F]AlF-FAPI-74 identifies a lesion as malignant (true positive) with effective upstaging. 2. [18F]AlF-FAPI-74 identifies a lesion as non-malignant (true negative) with effective downstaging. 3. [18F]AlF-FAPI-74 can differentiate between a malignant or non-malignant lesion when there is doubt. 4. Other implications that are deemed contributory by the treating physician.
Endpoint(s): See trial synopsis

Source: https://euclinicaltrials.eu/ctis-public/view/2024-512059-19-00